EU clinical trial 2024-513234-37-00: A study investigating the safety, absorption, and elimination of radioactively labeled RO7269162, a new compound that may potentially be used in the treatment of Alzheimer’s disease.
Protocol code: BP45325
Sponsor: F. Hoffmann-La Roche AG (Pharmaceutical company). Phase: Human Pharmacology (Phase I)- Other. Countries: Netherlands (ended).
Therapeutic area(s): Not possible to specify
Gender: Male. Age: 18-64 years. Enrolment: 10.
Status: Ended. Start date (EU): 2024-10-16. End date (EU): 2025-01-29. Decision date: 2024-10-10. Results received: No. Last updated: 2024-11-06.
Decision dates by country: NL: 2024-11-06

Condition(s): Healthy males volunteers

Source: https://euclinicaltrials.eu/ctis-public/view/2024-513234-37-00